EU clinical trial 2023-507897-42-00: Double-blind, randomised, placebo-controlled, phase IIa trial on the efficacy and tolerability of an 8-week treatment with two different doses of budesonide orodispersible tablets vs. placebo for prevention of oesophageal strictures in adult patients after endoscopic submucosal dissection
Protocol code: BUL-5/ESD
Sponsor: Dr. Falk Pharma GmbH (Pharmaceutical company). Phase: Therapeutic exploratory (Phase II). Countries: Germany (ended), Sweden (ended), Portugal (ended), Netherlands (ended), Poland (ended), France (ended), Spain (ended).
Therapeutic area(s): Diseases [C] - Digestive System Diseases [C06]
Gender: Female, Male. Age: 18-64 years, 65+ years. Enrolment: 93.
Status: Ended. Start date (EU): 2020-05-12. End date (EU): 2026-03-30. End date: 2026-03-31. Decision date: 2023-11-22. Results received: No. Last updated: 2026-02-11.
Decision dates by country: PT: 2023-12-11, SE: 2023-11-22, NL: 2023-12-08, ES: 2024-11-15, DE: 2023-12-07, PL: 2024-02-09, FR: 2024-11-28

Condition(s): Prevention of oesophageal strictures in adult patients after endoscopic submucosal dissection
Product: BUL02, Placebo orodispersible tablets, BUL03

Primary endpoint: Percentage of patients free of strictures at visit week 8
Endpoint(s): Number of endoscopic dilations per patient during the DB treatment phase, Percentage of patients free of strictures until the FU visit

Source: https://euclinicaltrials.eu/ctis-public/view/2023-507897-42-00